EU clinical trial 2024-518101-18-02: Exploring the Pharmacomicrobiomics of Depression
Protocol code: NL79264.091.21
Sponsor: Radboud universitair medisch centrum Stichting (Hospital/Clinic/Other health care facility). Phase: Therapeutic use (Phase IV). Countries: Netherlands (ended).
Therapeutic area(s): Psychiatry and Psychology [F] - Mental Disorders [F03]
Gender: Female, Male. Age: 18-64 years. Enrolment: 25.
Status: Ended. End date (EU): 2026-02-23. Decision date: 2025-01-17. Results received: No. Last updated: 2025-01-17.

Condition(s): Major Depressive Disorder
Product: VENLAFAXINE

Primary endpoint: The primary outcomes are the association between medication induced changes in gut microbial profile, depression symptoms and side effects
Endpoint(s): A secondary outcome is the role of therapeutic blood plasma levels (reflecting drug absorption) in the association between medication-induced changes in the gut microbial profile and treatment efficacy.

Source: https://euclinicaltrials.eu/ctis-public/view/2024-518101-18-02